EU clinical trial 2024-514723-42-00: A Phase I/II Multicenter, Open-Label Study of Nous-209 Genetic Vaccine for the Treatment of Microsatellite Unstable Solid Tumors
Protocol code: NOUS-209-01
Sponsor: Nouscom S.r.l. (Pharmaceutical company). Phase: Phase I and Phase II (Integrated)- Other. Countries: Belgium (ongoing, recruitment ended), Spain (ongoing, recruitment ended), Italy (ongoing, recruitment ended).
Therapeutic area(s): Diseases [C] - Neoplasms [C04]
Gender: Female, Male. Age: 18-64 years, 65+ years. Enrolment: 81.
Status: Ongoing, recruitment ended. Start date (EU): 2022-05-05. Decision date: 2024-08-26. Results received: No. Last updated: 2025-07-04.
Decision dates by country: BE: 2024-08-26, IT: 2024-09-23, ES: 2024-08-26

Condition(s): Locally advanced unresectable or metastatic, microsatellite instability high (MSI-H) or dMMR CRC
Product: GAd20-209-FSP, MVA-209-FSP, KEYTRUDA 25 mg/mL concentrate for solution for infusion

Primary endpoint: For Phase IIa: ORR assessed by standard RECIST v 1.1 criteria For Phase II b (Cohorts C and D): ORR assessed by standard RECIST v 1.1 criteria
Endpoint(s): For Phase IIa Safety and tolerability: AEs as characterized by type, severity (graded by the NCI CTCAE v.5.0), timing, seriousness, and relationship to study treatments. Efficacy assessed by standard RECIST v1.1 criteria: BOR,DoR, and PFS at 6, 12, 18, and 24 months. For Phase IIb (Cohorts C and D) Safety and tolerability: AEs as characterized by type, severity (graded by the NCI CTCAE v.5.0), timing, seriousness, and relationship to study treatments. Efficacy assessed by standard RECIST v

Source: https://euclinicaltrials.eu/ctis-public/view/2024-514723-42-00